EU clinical trial 2025-523650-14-00: functional imaging of digital osteoarthritis and rheumatoid arthritis using 99mTc-NTP15-5 in nuclear medicine : phase II clinical study
Protocol code: CARSPECT-II
Sponsor: Centre Jean Perrin (Patient organisation/association). Phase: Therapeutic exploratory (Phase II). Countries: France (authorised, recruitment pending).
Therapeutic area(s): Not possible to specify
Gender: Female, Male. Age: 18-64 years, 65+ years. Enrolment: 80.
Status: Authorised, recruitment pending. Decision date: 2026-07-24. Results received: No. Last updated: 2026-07-24.

Condition(s): Arthritis rheumatoid and finger osteoarthritis
Product: 99mTc NTP15-5

Primary endpoint: The diagnostic accuracy of 99mTc-NTP 15-5 imaging in detecting an abnormal joint among the 15 joints of the hands. The scintigraphic analysis of the joints will be visual, blinded to the pathology, and binary in nature. A joint will be considered pathological on 99mTc-NTP 15-5 in the event of abnormal tracer uptake, compared to joints with physiological uptake. The diagnosis of a pathological joint (gold standard) will be based on a composite radiological-clinical analysis.
Endpoint(s): Performance measures of 99mTc-NTP 15-5 imaging for distinguishing between DAO and RA. Readers will classify the scintigrams as DAO or RA based on the uptake pattern. A consensus will be sought in cases of disagreement. The gold standard will be the diagnosis determined by radioclinical analysis., Performance measures for 99mTc-NTP 15-5 imaging to detect an affected joint complex, including: - For RA: MCP joints of the 2nd–5th fingers and IP joints of the 2nd–5th fingers - For DOA: CMC joints of the 2nd–5th fingers, IP joints of the 2nd–5th fingers, and 1R (CMC, MCP, and IP joints of the 1st finger), The proportion of joints classified as pathological, according to the scintigraphic method and the radiographic-clinical method., Measurements of the radial joint-diaphysis ratio (99mTc-NTP 15-5J/D) determined by semi-automatic tracing of joint interfaces on scintigraphic images and manually traced spherical regions of interest on the radial diaphyses, Inter-observer reproducibility measures: Cohen’s kappa coefficient for visual readings (prior to consensus) and ICC for quantitative readings., All skeletal joints other than the hands will be rated by a score identical to that used during phase I: 0: no fixation, 1: fixation < adjacent diaphysis, 2: fixation = adjacent diaphysis, 3: fixation > adjacent diaphysis, Adverse events classified according to the NCI-CTCAE V5.0 criteria and associated with 99mTc-NTP 15-5 occurring within one week of injection

Source: https://euclinicaltrials.eu/ctis-public/view/2025-523650-14-00